EU clinical trial 2026-525360-18-00: A First-in-Human Study of INCA035784 in Participants With Myeloproliferative Neoplasms
Protocol code: INCA035784-101
Sponsor: Incyte Corp. (Pharmaceutical company). Phase: Human Pharmacology (Phase I)- First administration to humans. Countries: Italy (authorised, recruitment pending), Belgium (authorised, recruitment pending), Germany (authorised, recruitment pending).
Therapeutic area(s): Diseases [C] - Neoplasms [C04]
Gender: Female, Male. Age: 18-64 years, 65+ years. Enrolment: 40.
Status: Authorised, recruitment pending. Decision date: 2026-08-03. Results received: No. Last updated: 2026-08-07.
Decision dates by country: BE: 2026-08-03, DE: 2026-08-07, IT: 2026-08-05

Condition(s): Myeloproliferative Neoplasms

Source: https://euclinicaltrials.eu/ctis-public/view/2026-525360-18-00